EU clinical trial 2024-510945-32-00: A Randomized, Placebo-Controlled, Double-Blind, Parallel Group, Phase 3 Study to Evaluate the Efficacy and Safety of Subcutaneous CT-P13 in Patients with Moderately to Severely Active Rheumatoid Arthritis
Protocol code: CT-P13 3.11
Sponsor: Celltrion Inc. (Pharmaceutical company). Phase: Therapeutic confirmatory (Phase III). Countries: Poland (ended).
Therapeutic area(s): Diseases [C] - Musculoskeletal Diseases [C05]
Gender: Female, Male. Age: 18-64 years, 65+ years. Enrolment: 189.
Status: Ended. Start date (EU): 2024-12-17. End date (EU): 2026-04-13. Decision date: 2024-12-16. Results received: No. Last updated: 2026-02-05.

Condition(s): Rheumatoid arthritis
Product: HYDROXYCHLOROQUINE, METHOTREXATE, Remsima 120 mg solution for injection in pre-filled pen, METHOTREXATE, IBUPROFEN, Placebo (To evaluate the efficacy and safety of CT-P13, and mainatain blindness during the study, Placebo will be administered.), PARACETAMOL, FOLIC ACID, HYDROCORTISONE

Primary endpoint: Proportion of patients achieving clinical response according to the ACR20 criteria at Week 12.

Source: https://euclinicaltrials.eu/ctis-public/view/2024-510945-32-00